EU clinical trial 2023-507961-24-00: A Phase 3, Multicenter, Randomized, Open-Label, Active-Controlled Study of Trastuzumab Deruxtecan (T-DXd) Versus Trastuzumab Emtansine (T-DM1) in Subjects with High-Risk HER2-Positive Primary Breast Cancer Who Have Residual Invasive Disease in Breast or Axillary Lymph Nodes Following Neoadjuvant Therapy
Protocol code: DS8201-A-U305
Sponsor: Daiichi Sankyo Inc. (Pharmaceutical company). Phase: Therapeutic confirmatory (Phase III). Countries: Czechia (ongoing, recruitment ended), Poland (ongoing, recruitment ended), Germany (ongoing, recruitment ended), Netherlands (ongoing, recruitment ended), Spain (ongoing, recruitment ended), Ireland (ongoing, recruitment ended), Romania (ongoing, recruitment ended), Greece (ongoing, recruitment ended), France (ongoing, recruitment ended), Belgium (ongoing, recruitment ended), Italy (ongoing, recruitment ended), Denmark (ongoing, recruitment ended), Portugal (ongoing, recruitment ended).
Therapeutic area(s): Diseases [C] - Neoplasms [C04]
Gender: Female, Male. Age: 18-64 years, 65+ years. Enrolment: 1124.
Status: Ongoing, recruitment ended. Start date (EU): 2021-04-19. Decision date: 2024-07-10. Results received: No. Last updated: 2026-07-23.
Decision dates by country: DK: 2024-07-12, PT: 2024-07-12, IT: 2024-07-29, PL: 2024-08-04, CZ: 2024-07-11, IE: 2024-07-10, BE: 2024-07-15, GR: 2024-07-22, ES: 2024-07-10, NL: 2024-07-10, RO: 2024-08-07, FR: 2024-07-11, DE: 2024-07-19

Condition(s): High-Risk HER2-Positive Breast Cancer
Product: Kadcyla 160 mg powder for concentrate for solution for infusion., Kadcyla 100 mg powder for concentrate for solution for infusion., DS-8201a

Primary endpoint: IDFS is defined as the time from randomization until the first occurrence of ipsilateral locoregional invasive breast cancer recurrence, distant recurrence, contralateral invasive breast cancer, or death from any cause., IDFS will be determined based on disease recurrence per Investigator assessment based on all available clinical assessments.
Endpoint(s): DFS is defined as the time between randomization and the date of the first occurrence of an IDFS event including second primary non-breast cancer event or contralateral or ipsilateral DCIS. DFS will be determined based on disease recurrence per Investigator assessment., OS is defined as the time from randomization to death due to any cause., DRFI is defined as the time between randomization and the date of distant breast cancer recurrence. DRFI will be determined based on disease recurrence per Investigator assessment., BMFI is defined as time from randomization to documentation of involvement of the CNS by metastatic cancer including parenchymal brain and spinal cord metastases as well as leptomeningeal carcinomatosis. BMFI will be determined based on disease recurrence per Investigator assessment., AEs including SAEs, TEAEs, and AESIs Physical examination findings, ECOG PS, vital sign measurements, standard clinical laboratory parameters, ECG parameters, ECHO/MUGA findings, and CT scans, Serum concentrations of T-DXd, total anti HER2 antibody, and MAAA 1181a in the PK sampling cohort, Percentage of subjects who are positive for ADAs at baseline, and postbaseline and treatment-emergent ADA positive. Titer and NAb will be determined for positive ADA samples.

Source: https://euclinicaltrials.eu/ctis-public/view/2023-507961-24-00